EU clinical trial 2023-507007-60-00: CareCN: A phase I/II, open-label, study to evaluate the safety and efficacy of an intravenous injection of GNT0003 (Adeno-associated Viral Vector expressing the UGT1A1 transgene) in patients with severe Crigler-Najjar syndrome requiring phototherapy
Protocol code: GNT-012-CRIG
Sponsor: Genethon (Laboratory/Research/Testing facility). Phase: Phase I and Phase II (Integrated)- First administration to humans. Countries: Netherlands (ongoing, recruiting), France (ongoing, recruiting), Italy (ongoing, recruiting).
Therapeutic area(s): Diseases [C] - Nutritional and Metabolic Diseases [C18]
Gender: Female, Male. Age: 0-17 years, 18-64 years, 65+ years. Enrolment: 17.
Status: Ongoing, recruiting. Start date (EU): 2018-04-09. Decision date: 2023-11-07. Results received: No. Last updated: 2026-08-06.
Decision dates by country: IT: 2023-12-01, NL: 2023-11-07, FR: 2023-11-07

Condition(s): severe Crigler-Najjar syndrome in patients requiring phototherapy
Product: rAAV8-hUGT1A1, PREDNISONE, AMOXICILLIN, METHYLPREDNISOLONE, PREDNISOLONE, SULFAMETHOXAZOLE AND TRIMETHOPRIM, SIROLIMUS

Primary endpoint: Dose escalation part: Incidence of treatment-emergent adverse events (TEAEs) or treatment-emergent serious adverse events (TESAEs) up to Week 17, Dose escalation part: Change in laboratory parameters, vital signs and in physical examination from baseline to Week 17, Confirmatory part: The proportion of patients having received the selected dose of GNT0003 with serum total bilirubin ≤ 300 µmol/L at Week 48 after IMP infusion and without phototherapy from Week 16
Endpoint(s): Dose escalation part: Time to GNT0003 vector clearance from blood, urine, saliva and feces, Dose escalation part: Number of patients with serum total bilirubin ≤ 300 µmol/L within 7 days after interruption of daily phototherapy, Confirmatory part: Incidence of treatment-emergent adverse events (TEAEs) or treatment-emergent serious adverse events (TESAEs) up to Week 48, Confirmatory part: Change in laboratory parameters, vital signs and in the physical examination from baseline up to Week 48, Confirmatory part: Change in serum total bilirubin from baseline up to Week 48, Confirmatory part: Change in bilirubin/albumin ratio from baseline up to Week 48, Confirmatory part: Change in Health-related quality of life as measured by QOL questionnaires, SF-36 (adult) and PedsQL (pediatric), and by the quality of sleep questionnaire from baseline up to Week 48., Confirmatory part: Time to GNT0003 vector clearance from blood, urine, saliva and feces, Proportion of patients achieving sustained discontinuation of phototherapy up to 120 months, with assessment of: Duration of phototherapy discontinuation, Time to phototherapy restart (if applicable), Daily duration of phototherapy after restart., Proportion of patients achieving sustained discontinuation of phototherapy up to Week 48, with assessment of: - Duration of phototherapy discontinuation, - Time to phototherapy restart (if applicable), - Daily duration of phototherapy after restart.

Source: https://euclinicaltrials.eu/ctis-public/view/2023-507007-60-00